EU clinical trial 2024-513631-25-00: A Randomized, Double-blind, Placebo Controlled Phase 3 Study of Venetoclax in Combination with Azacitidine Versus Azacitidine in Treatment Naïve Subjects with Acute Myeloid Leukemia who are Ineligible for Standard Induction Therapy, Incorporating Extension Period - Continued Access for Venetoclax. (VIALE-A)
Protocol code: M15-656
Sponsor: AbbVie Deutschland GmbH & Co. KG (Pharmaceutical company). Phase: Therapeutic confirmatory (Phase III). Countries: Finland (ended), Czechia (ended), Hungary (ended), Spain (ended), France (ended), Belgium (ended).
Therapeutic area(s): Diseases [C] - Neoplasms [C04]
Gender: Female, Male. Age: 18-64 years, 65+ years. Enrolment: 83.
Status: Ended. Start date (EU): 2017-08-17. End date (EU): 2025-09-15. Decision date: 2024-07-15. Results received: No. Last updated: 2025-09-18.
Decision dates by country: HU: 2024-07-15, ES: 2024-07-15, CZ: 2024-07-15, BE: 2024-07-15, FR: 2024-07-17, FI: 2024-07-15

Condition(s): Acute Myeloid Leukemia
Product: Venetoclax, Venetoclax, Matching Placebo for Venetoclax, Venetoclax, AZACITIDINE

Primary endpoint: Rate of complete remission (CR) or complete remission with incomplete marrow recovery (CRi), Overall Survival (OS)
Endpoint(s): Event-Free Survival (EFS), CR + CRi rate by the initiation of Cycle 2, Patient Reported Outcomes Measurement Information System (PROMIS) Cancer Fatigue Short Form [SF] 7a and European Organization for Research and Treatment of Cancer Quality of Life Questionnaire Core [EORTC QLQ-C30]).

Source: https://euclinicaltrials.eu/ctis-public/view/2024-513631-25-00